EU clinical trial 2023-506703-26-00: Efficacy and safety of conventional neoadjuvant therapy versus total neoadjuvant therapy in older patients with locally advanced rectal cancer: a multicentre, open-label, randomised pragmatic clinical trial
Protocol code: IJB-SHAPERS-ODN-013
Sponsor: Institut Jules Bordet (Hospital/Clinic/Other health care facility). Phase: Therapeutic confirmatory (Phase III). Countries: Belgium (ongoing, recruiting).
Therapeutic area(s): Diseases [C] - Neoplasms [C04]
Gender: Female, Male. Age: 65+ years. Enrolment: 264.
Status: Ongoing, recruiting. Start date (EU): 2024-02-07. Decision date: 2024-01-08. Results received: No. Last updated: 2026-07-28.

Condition(s): locally advanced rectal cancer
Product: FOLINIC ACID, ONDANSETRON, DEXAMETHASONE, FLUOROURACIL, METOCLOPRAMIDE, OXALIPLATIN, CAPECITABINE

Primary endpoint: The primary endpoint is Net Benefit Treatment, according to the following hierarchical outcome measures: 1. Overall survival at 3 years after randomisation 2. Progression-free survival at 3 years after randomisation 3. Increased-grade peripheral sensory neuropathy at 3 years after randomisation 4. Grade ≥3 toxicities during treatment
Endpoint(s): Safety of study treatments defined as the frequency of adverse events reported according to NCI Common Terminology Criteria for Adverse Events (CTCAE) Version 5.0., Quality of Life based on EORTC-QLQ-C30, EORTC-QLQ-C29, EORTC-QLQ-CIPN20 and EQ-5Q-5L questionnaires, Compliance to treatment, Pathological complete response, R0 resection, Organ preservation, Use of healthcare resources

Source: https://euclinicaltrials.eu/ctis-public/view/2023-506703-26-00